EU clinical trial 2024-515680-61-00: An Open-Label Extension Trial to Assess the Long-Term Safety of ZX008 (Fenfluramine Hydrochloride) Oral Solution as an Adjunctive Therapy for Seizures in Patients with Rare Seizure Disorders Such as Epileptic Encephalopathies Including Dravet Syndrome and Lennox-Gastaut Syndrome
Protocol code: ZX008-1900(EP0215)
Sponsor: Zogenix International Limited (Pharmaceutical company). Phase: Therapeutic confirmatory (Phase III). Countries: Spain (ended), Netherlands (ended), Poland (ended), Italy (ended).
Therapeutic area(s): Diseases [C] - Nervous System Diseases [C10]
Gender: Female, Male. Age: 0-17 years, 18-64 years. Enrolment: 104.
Status: Ended. Start date (EU): 2020-02-07. End date (EU): 2025-05-08. End date: 2025-05-09. Decision date: 2024-09-16. Results received: Yes. Last updated: 2025-01-31.
Decision dates by country: IT: 2024-11-05, ES: 2024-09-19, PL: 2024-09-30, NL: 2024-09-16

Condition(s): Dravet syndrome or Lennox-Gastaut syndrome
Product: Fintepla 2.2 mg/ml oral solution

Primary endpoint: The safety endpoints of the study are: • AEs • Laboratory safety (hematology, chemistry) • Vital signs (blood pressure, heart rate, temperature, and respiratory rate) • Physical examination • Neurological examination • Electrocardiogram (ECGs) • Doppler echocardiogram (ECHOs) • Body weight/height • Chest x-ray (subjects in France and Netherlands only) • Electroencephalogram (EEG) (in Italy only)
Endpoint(s): The effectiveness endpoints of the study are: • CGI-I, global and symptomatic, as assessed by parent/caregiver • CGI-I, global and symptomatic, as assessed by investigator (or designee) • Percent improvement in seizure burden as assessed by the investigator (or designee)

Source: https://euclinicaltrials.eu/ctis-public/view/2024-515680-61-00